EU clinical trial 2024-520219-42-00: adIVO – A phase II trial of ivosidenib maintenance after SOC adjuvant chemotherapy in curative mIDH1 cholangiocarcinoma
Protocol code: adIVO
Sponsor: Frankfurter Institut Fuer Klinische Krebsforschung IKF GmbH (Pharmaceutical company). Phase: Phase II and Phase III (Integrated). Countries: Germany (ongoing, recruiting).
Therapeutic area(s): Diseases [C] - Digestive System Diseases [C06]; Diseases [C] - Neoplasms [C04]
Gender: Female, Male. Age: 18-64 years, 65+ years. Enrolment: 40.
Status: Ongoing, recruiting. Start date (EU): 2025-11-18. Decision date: 2025-09-04. Results received: No. Last updated: 2026-07-09.

Condition(s): ivosidenib maintenance after SOC adjuvant chemotherapy in curative mIDH1 cholangiocarcinoma
Product: Tibsovo 250 mg film-coated tablets

Primary endpoint: 1-year recurrence-free survival rate (RFS@1year), defined as proportion of patients alive with no disease recurrence 1 year after start of maintenance ivosidenib
Endpoint(s): RFS, defined as time from start of ivosidenib maintenance to the date of disease recurrence or death to any cause, Time to recurrence (TTR), defined as time from start of ivosidenib maintenance to the date of disease recurrence, Time to treatment failure (TTF), defined as time from start of ivosidenib maintenance to the date of premature treatment discontinuation from any cause, including disease recurrence, treatment toxicity or death, Overall survival (OS), defined as time from enrollment to the date of death from any cause, Safety, Quality of life using EORTC QLQ-C30 and EORTC QLQ-BIL21 questionnaires

Source: https://euclinicaltrials.eu/ctis-public/view/2024-520219-42-00